EU clinical trial 2022-502446-27-00: A Phase 3 Randomized Study Comparing Talquetamab in Combination with Pomalidomide (Tal-P), Talquetamab in Combination with Teclistamab (Tal-Tec), and Investigator’s Choice of Either Elotuzumab, Pomalidomide, and Dexamethasone (EPd) or Pomalidomide, Bortezomib, and Dexamethasone (PVd) in Participants with Relapsed or Refractory Myeloma who Have Received 1 to 4 Prior Lines of Therapy Including an Anti-CD38 Antibody and Lenalidomide
Protocol code: 64407564MMY3009
Sponsor: Janssen - Cilag International (Pharmaceutical company). Phase: Therapeutic confirmatory (Phase III). Countries: Sweden (ongoing, recruitment ended), Belgium (ongoing, recruitment ended), Austria (ongoing, recruitment ended), France (ongoing, recruitment ended), Czechia (ongoing, recruitment ended), Greece (ongoing, recruitment ended), Spain (ongoing, recruitment ended), Netherlands (ongoing, recruitment ended), Denmark (ongoing, recruitment ended), Italy (ongoing, recruitment ended), Poland (ongoing, recruitment ended), Germany (ongoing, recruitment ended), Hungary (ongoing, recruitment ended).
Therapeutic area(s): Diseases [C] - Neoplasms [C04]
Gender: Female, Male. Age: 18-64 years, 65+ years. Enrolment: 470.
Status: Ongoing, recruitment ended. Start date (EU): 2024-02-26. Decision date: 2024-02-13. Results received: No. Last updated: 2026-05-18.
Decision dates by country: AT: 2024-02-29, BE: 2024-02-13, CZ: 2024-02-13, DK: 2024-02-13, FR: 2024-02-14, DE: 2024-02-21, GR: 2024-02-29, HU: 2024-02-16, IT: 2024-02-16, ES: 2024-02-14, SE: 2024-02-15, NL: 2024-02-21, PL: 2024-02-16

Condition(s): Relapsed or Refractory Myeloma
Product: Privigen 100 mg/ml solution for infusion, Fortecortin® 2 mg Tabletten, Dexamethason 8 mg GALEN® Tabletten, Privigen 100 mg/ml solution for infusion, teclistamab, JNJ-64407564, Pomalidomide, Dexamethasone Tablets BP 2.0mg, Imnovid 3 mg hard capsules, Pomalidomide, Imnovid 1 mg hard capsules, Empliciti 400 mg powder for concentrate for solution for infusion., Empliciti 300 mg powder for concentrate for solution for infusion., Pomalidomide, VELCADE 3.5 mg powder for solution for injection, Privigen 100 mg/ml solution for infusion, teclistamab, Pomalidomide, Imnovid 4 mg hard capsules, JNJ-64407564, Imnovid 2 mg hard capsules

Primary endpoint: Progression-Free Survival

Source: https://euclinicaltrials.eu/ctis-public/view/2022-502446-27-00